EU clinical trial 2025-522274-37-00: A Phase 1b/2 Clinical Study to Evaluate the Safety, Tolerability, Pharmacokinetics and Clinical Activity of GSK5764227 in combination with Standard of Care (SoC) or other agents in Participants with Advanced Solid Tumors
Protocol code: 300148
Sponsor: Glaxosmithkline Research & Development Limited (Pharmaceutical company). Phase: Phase I and Phase II (Integrated)- Other. Countries: Spain (ongoing, recruiting).
Therapeutic area(s): Diseases [C] - Neoplasms [C04]
Gender: Female, Male. Age: 18-64 years, 65+ years. Enrolment: 15.
Status: Ongoing, recruiting. Start date (EU): 2025-12-03. Decision date: 2025-11-21. Results received: No. Last updated: 2026-05-18.

Condition(s): Neoplasms
Product: Bendafolin 10 mg/ml Injektionslösung, Benda-5 FU 50 mg/ml Injektionslösung, Xtandi - 40 mg film-coated tablets, Zirabev 25 mg/ml concentrate for solution for infusion, BENDAFOLIN 10 mg/ml Injektionslösung, 5-FLUOROURACIL–EBEWE, 50 MG/ML, ROZTWÓR DO WSTRZYKIWAN I INFUZJI, 5-Флуороурацил Ебеве 50 mg/ml концентрат за инжекционен и инфузионен разтвор., Calciumfolinat Kabi 10 mg/ml Injektions-/Infusionslösung, 5-FU medac 50 mg/ml, Injektionslösung, Zirabev 25 mg/ml concentrate for solution for infusion

Primary endpoint: Incidence of AEs using NCI-CTCAE v5.0, including DLTs and change in safety parameters: • Incidence and severity of AEs/SAEs/AESIs and AEs leading to dose modifications • Vital signs, body weight, laboratory tests (hematology, clinical chemistry, urinalysis), cardiac function (ECG), and ECOG performance status changes
Endpoint(s): Observed PK concentrations of GSK5764227 (conjugated antibody) and GSK5757810 (payload)., ADA and NAb incidence and ADA titers against GSK5764227, ORR, defined as the proportion of participants who have achieved BOR of confirmed CR or PR as assessed by investigator, according to RECIST 1.1 (Cohort A) or per PCWG3 (Cohort B)., DCR18, defined as the proportion of participants who have achieved CR or PR, or SD of ≥17 weeks as assessed by investigator according to PCWG3 (Cohort B)., DoR, defined as the time from the date of the first documented objective response (CR/PR) as assessed by investigator according to RECIST 1.1 (Cohort A) or PCWG3 (Cohort B), until the date of the first documented PD or death due to any cause, whichever is earlier, PFS defined as the time from the date of first dose until the earliest date of documented disease progression as assessed by investigator according to RECIST 1.1 (Cohort A), rPFS (Cohort B): defined as the time from the date of first dose until the earliest date of documented PD per PCWG3-modified RECIST 1.1 (soft tissue lesion assessment) and/or PCWG3 bone lesion assessment (Cohort B)] or death due to any cause., PSA50 response defined as a ≥50% decline in PSA levels from baseline (Cohort B)

Source: https://euclinicaltrials.eu/ctis-public/view/2025-522274-37-00